EU clinical trial 2024-519059-28-00: A phase III, randomized, open-label, blinded endpoint, comparative trial of ferric derisomaltose versus no intravenous iron in iron-deficient subjects with symptomatic chronic heart failure
Protocol code: P-Monofer-CHF-02
Sponsor: Pharmacosmos A/S (Pharmaceutical company). Phase: Therapeutic confirmatory (Phase III). Countries: Poland (ongoing, recruiting), Lithuania (ongoing, recruiting), Croatia (ongoing, recruiting), Hungary (ongoing, recruiting), Slovakia (ongoing, recruiting), Latvia (ongoing, recruiting), Portugal (ongoing, recruiting), Bulgaria (ongoing, recruiting), Romania (ongoing, recruiting), Czechia (ongoing, recruiting), Denmark (ongoing, recruiting), Norway (ongoing, recruiting).
Therapeutic area(s): Diseases [C] - Cardiovascular Diseases [C14]
Gender: Female, Male. Age: 18-64 years, 65+ years. Enrolment: 948.
Status: Ongoing, recruiting. Start date (EU): 2025-07-17. Decision date: 2025-06-19. Results received: No. Last updated: 2026-07-23.
Decision dates by country: LT: 2025-06-20, SK: 2025-06-19, RO: 2025-06-24, PL: 2025-06-24, HR: 2025-06-24, BG: 2025-06-20, HU: 2025-06-20, LV: 2025-06-25, CZ: 2025-06-20, PT: 2025-06-20, DK: 2026-02-24, NO: 2026-02-11

Condition(s): Chronic Heart Failure
Product: Monofer, injektions- og infusionsvæske, opløsning

Primary endpoint: Primary efficacy endpoint: Number of cardiovascular deaths and hospitalizations for worsening heart failure
Endpoint(s): Key Secondary efficacy endpoints: • Time to first hospitalization for worsening heart failure or cardiovascular death, Key Secondary efficacy endpoints: • Number of hospitalizations for worsening heart failure, Key Secondary efficacy endpoints: • Number of all-cause hospitalizations, Key Secondary efficacy endpoints: • Time to cardiovascular death, Key Secondary efficacy endpoints: • Time to all-cause death, Secondary efficacy endpoints: • Number of hospitalizations for cardiovascular, respiratory, or renal disease, Secondary efficacy endpoints: • Time to cardiovascular, respiratory, or renal death, Secondary efficacy endpoints: • Number of hospitalizations for cardiovascular events: stroke, acute myocardial infarct (AMI), and heart failure, Secondary efficacy endpoints: • Time to cardiovascular death or first hospitalization for cardiovascular event: stroke, AMI, and heart failure, Secondary efficacy endpoints: • Time to all-cause death or first hospitalization, Secondary efficacy endpoints: • Days hospitalized or dead for cardiovascular reasons at week 52, Secondary efficacy endpoints: • Days hospitalized or dead for any reason at week 52, Secondary efficacy endpoints: • Change in New York Heart Association (NYHA) from baseline to weeks 12, 26, and 52, Secondary efficacy endpoints: • All-cause rehospitalizations at 30 and 60 days, Secondary efficacy endpoints: • Rehospitalizations for worsening heart failure at 30 and 60 days, Secondary efficacy endpoints: • Number of cardiovascular deaths and hospitalizations for worsening heart failure including urgent and unscheduled outpatient IV diuretic treatment, Secondary efficacy endpoints: • Number of urgent and unscheduled outpatient IV diuretic treatment, PD endpoint: Change in Hb, s-ferritin, TSAT, s-iron, and TIBC from baseline to weeks 26 and 52, Safety endpoints: • Type and incidence of serious adverse events (SAEs), Safety endpoints: • In addition, vital signs and safety laboratory parameters will be measured as part of standard safety assessments.

Source: https://euclinicaltrials.eu/ctis-public/view/2024-519059-28-00